EU clinical trial 2022-501620-26-00: Rifampicin Combination Therapy versus Targeted Antimicrobial Monotherapy in the Oral Antimicrobial Treatment Phase of Staphylococcal Prosthetic Joint Infection
Protocol code: 2022-501620-26-00
Sponsor: Leiden University Medical Center (Hospital/Clinic/Other health care facility). Phase: Therapeutic use (Phase IV). Countries: Netherlands (ongoing, recruiting).
Therapeutic area(s): Diseases [C] - Bacterial Infections and Mycoses [C01]; Diseases [C] - Musculoskeletal Diseases [C05]
Gender: Female, Male. Age: 18-64 years, 65+ years. Enrolment: 316.
Status: Ongoing, recruiting. Start date (EU): 2023-05-15. Decision date: 2023-02-23. Results received: No. Last updated: 2026-04-28.

Condition(s): prosthetic joint infection
Product: Levofloxacin 500 mg film-coated tablets, Rifampicin 300 mg Capsules, Moxifloxacin Tillomed 400 mg film coated tablets, Cotrimoxazol AL Sulfamethoxazol 400 mg/Trimethoprim 80 mg pro Tablette, Clindamycin 300mg Capsules, hard, Ciprofloxacin-ratiopharm® 500 mg Filmtabletten, Minocycline Teva 50 mg, omhulde tabletten, Doxycycline Aurobindo Disper 100 mg, tabletten.

Primary endpoint: treatment success 15 months after DAIR (=1 year after finishing antibiotic treatment). Treatment success will be defined as absence of all of the following: (I) Infection related re-surgery of the initially affected prosthetic joint (II) New antibiotic treatment for suspected or proven infection of the index joint. (III) Ongoing use of antibiotics for the index joint at the end of follow-up. (IV) Death
Endpoint(s): Quality of life, measured with EQ-5D-5L questionnaires. This ‘quality of life’ questionnaire will be scored at the time of randomization, at week 6 after surgical debridement and after 3 months., The number of (S)AEs during antimicrobial treatment and follow up (including mortality)., The number of switches to a different oral regimen, The number of antibiotic side effects (classified by the modified Hartwig and Siegel scale)., The number of patients developing Clostridioides difficile infection during treatment., The occurrence of rifampicin resistance in bacteria in patients with a microbiologically confirmed failure of treatment, The difference in absolute risks of treatment succes with death unrelated to PJI as a competing event in a per-protocol analysis, The difference in absolute risks of treatment success in an intention to treat analysis

Source: https://euclinicaltrials.eu/ctis-public/view/2022-501620-26-00